EU clinical trial 2023-505161-81-00: A Phase IV Open-Label Study Evaluating the Effectiveness and Safety of Risdiplam Administered in Pediatric Patients with Spinal Muscular Atrophy who Experienced a Plateau or Decline in Function After Gene Therapy
Protocol code: BN44621
Sponsor: F. Hoffmann-La Roche AG (Pharmaceutical company). Phase: Therapeutic use (Phase IV). Countries: Poland (ongoing, recruiting), Germany (ongoing, recruiting).
Therapeutic area(s): Diseases [C] - Musculoskeletal Diseases [C05]
Gender: Female, Male. Age: 0-17 years. Enrolment: 15.
Status: Ongoing, recruiting. Start date (EU): 2024-12-16. Decision date: 2024-02-27. Results received: No. Last updated: 2026-07-06.
Decision dates by country: PL: 2024-02-29, DE: 2024-05-24

Condition(s): Spinal Muscular Atrophy (SMA)
Product: RO7034067, Evrysdi 0.75 mg/mL powder for oral solution

Primary endpoint: Change from Baseline in the Raw Score of Bayley Scales of Infant and Toddler Development - Third Edition (BSID-III) Gross Motor Score at 72 Weeks of Risdiplam Treatment in this population of SMA patients
Endpoint(s): 1. Incidence and severity of adverse events, with severity determined according to the National Cancer Institute Common Terminology Criteria for Adverse Events, Version 5 (NCI CTCAE v5.0), 2. Incidence and severity of serious adverse events, 3. Incidence of treatment discontinuation due to adverse events

Source: https://euclinicaltrials.eu/ctis-public/view/2023-505161-81-00